EU clinical trial 2024-516319-25-00: Diagnostic Performance of Prostate Specific Membrane Antigen (PSMA) Positron Emission Tomography/Computed Tomography (PET/CT) Imaging for Pre-operative Lymph Node Assessment in Intermediate and High-risk Nonmetastasic Prostate Cancer
Protocol code: 29BRC20.0203
Sponsor: Centre Hospitalier Regional Et Universitaire De Brest (Hospital/Clinic/Other health care facility). Phase: Therapeutic exploratory (Phase II). Countries: France (ended).
Therapeutic area(s): Diseases [C] - Male Urogenital Diseases [C12]
Gender: Female, Male. Age: 18-64 years, 65+ years. Enrolment: 159.
Status: Ended. End date (EU): 2025-12-15. Decision date: 2024-11-26. Results received: No. Last updated: 2025-04-30.

Condition(s): Prostate Cancer
Product: 68GA-PSMA, Locametz 25 micrograms kit for radiopharmaceutical preparation

Primary endpoint: To evaluate the sensitivity, specificity and likelihood ratios of PET-PSMA for the detection of lymph node metastases in intermediate- or high-risk prostatic neoplasia in patients whose radical treatment by prostatectomy is selected by the multidisciplinary consultation meeting, by reference to the gold standard (reference test) obtained from histological data and/or imaging follow-up.
Endpoint(s): Modification of the surgical strategy for lymph node dissection on the basis of the PET-PSMA examination, compared with the strategy that would have been dictated by conventional imaging alone., Existence of a pathological focus according to each of the 3 examinations (PET-PSMA, MRI and anatomopathology = gold standard) for each of the 6 following locations: base, middle, prostatic apex (right and left), Positive predictive value of PET-PSMA in the detection of distant visceral or bone metastases, taking as the gold standard the diagnosis made by a review committee in the light of the patient's follow-up and the results available in current practice (clinical data, anatomopathology, repeated PSA tests and imaging)., Adverses events recorded during the assessment

Source: https://euclinicaltrials.eu/ctis-public/view/2024-516319-25-00